EU clinical trial 2023-508830-33-00: HER2-PREDICT: Translational study of tumor samples from patients treated with Trastuzumab Deruxtecan (T-DXd; DS-8201a)
Protocol code: SOLTI-1804
Sponsor: Solti Group (Laboratory/Research/Testing facility). Phase: Therapeutic exploratory (Phase II). Countries: Spain (ongoing, recruitment ended).
Therapeutic area(s): Diseases [C] - Neoplasms [C04]
Gender: Female. Age: 18-64 years, 65+ years. Enrolment: 180.
Status: Ongoing, recruitment ended. Start date (EU): 2019-12-13. Decision date: 2023-12-11. Results received: No. Last updated: 2026-04-02.

Condition(s): Patients diagnosed with advanced or metastatic cancer treated with Trastuzumab Deruxtecan in the context of a clinical trial/expanded access/ compassionate use or standard treatment, irrespective of histologic type.
Product: Enhertu 100 mg powder for concentrate for solution for infusion

Primary endpoint: To identify the optimal ERBB2 mRNA cut-point predictive of DS-8201 response -Correlation of mRNA ERBB2 levels (as a continuous variable) in baseline FFPE tumor samples with overall response in the DS8201a-treated cohorts., Correlation of mRNA ERBB2 levels (as a continuous variable) in baseline FFPE tumor samples with overall response in the DS8201a-treated cohorts.
Endpoint(s): To evaluate the association of mRNA ERBB2 levels with progression- free survival and overall survival., To evaluate the association of the PAM50 intrinsic subtypes (Luminal A, Luminal B, HER2-enriched and Basal-like) with overall response rate, progression free survival (PFS) and overall survival (OS)., To evaluate the association of immune-related genes with overall response, progression free survival (PFS) and overall survival (OS)., To design a new gene expression signature predictive of DS8201a benefit, To evaluate the benefit of DS8201a across somatic mutations., To correlate early changes in ctDNA with DS8201a benefit., To identify acquired somatic mutations of resistance to DS8201a upon progression in plasma samples

Source: https://euclinicaltrials.eu/ctis-public/view/2023-508830-33-00